EU clinical trial 2023-504716-15-00: A Phase 4, Multicenter, Randomized, Double-blind, Placebo-controlled Study Evaluating the Efficacy and Safety of Guselkumab Administered Subcutaneously in Bio-naive Subjects with Active Psoriatic Arthritis Axial Disease
Protocol code: CNTO1959PSA4002
Sponsor: Janssen - Cilag International (Pharmaceutical company). Phase: Therapeutic use (Phase IV). Countries: Spain (ongoing, recruitment ended), Portugal (ended), Bulgaria (ongoing, recruitment ended), Italy (ended), Poland (ongoing, recruitment ended), Denmark (ended), Slovakia (ongoing, recruitment ended), Hungary (ongoing, recruitment ended), Germany (ended), Sweden (ended), Czechia (ongoing, recruitment ended).
Therapeutic area(s): Diseases [C] - Immune System Diseases [C20]
Gender: Female, Male. Age: 18-64 years, 65+ years. Enrolment: 236.
Start date (EU): 2021-08-06. Decision date: 2024-05-02. Results received: No. Last updated: 2026-05-20.
Decision dates by country: PT: 2024-05-02, SE: 2024-05-06, DE: 2024-05-06, DK: 2024-05-02, IT: 2024-05-13, BG: 2024-05-21, CZ: 2024-05-02, ES: 2024-05-03, HU: 2024-05-03, PL: 2024-05-31, SK: 2024-05-02

Condition(s): Psoriatic Arthritis
Product: Guselkumab 1 mL PFS Placebo, Guselkumab - solution for injection in pre-filled syringe - 100 mg/mL

Primary endpoint: Change from baseline in BASDAI at Week 24.

Source: https://euclinicaltrials.eu/ctis-public/view/2023-504716-15-00